EU clinical trial 2023-507153-16-00: A Randomized, Double-Blind, Phase 3 Study Evaluating the Safety and Efficacy of Venetoclax in Combination with Azacitidine in Patients Newly Diagnosed with Higher-Risk Myelodysplastic Syndrome (Higher-Risk MDS)
Protocol code: M15-954
Sponsor: AbbVie Deutschland GmbH & Co. KG (Pharmaceutical company). Phase: Therapeutic confirmatory (Phase III). Countries: Czechia (ongoing, recruitment ended), Belgium (ongoing, recruitment ended), Austria (ongoing, recruitment ended), Spain (ongoing, recruitment ended), Netherlands (ongoing, recruitment ended), Germany (ongoing, recruitment ended), France (ongoing, recruitment ended), Italy (ongoing, recruitment ended), Poland (ongoing, recruitment ended).
Therapeutic area(s): Diseases [C] - Hemic and Lymphatic Diseases [C15]
Gender: Female, Male. Age: 18-64 years, 65+ years. Enrolment: 186.
Status: Ongoing, recruitment ended. Start date (EU): 2020-11-18. Decision date: 2023-12-12. Results received: No. Last updated: 2026-06-15.
Decision dates by country: PL: 2024-02-02, DE: 2023-12-28, NL: 2023-12-18, ES: 2023-12-13, BE: 2023-12-12, IT: 2024-02-01, CZ: 2023-12-13, FR: 2024-02-02, AT: 2023-12-15

Condition(s): Higher-Risk Myelodysplastic Syndrome
Product: Venetoclax, Venetoclax, Venetoclax, Placebo Venetoclax/ABT-199/Film-coated tablet Oral Use, Vidaza 25 mg/ml powder for suspension for injection

Primary endpoint: The primary endpoint of this study is Overall Survival.
Endpoint(s): Modified overall response (mOR) defined as complete remission (CR) + partial remission (PR) + marrow CR (mCR), Overall hematological improvement (HI) (platelet, neutrophil, or erythroid), Complete remission, Red blood cell (RBC) and platelet transfusion independence for subjects who are transfusion dependent on RBC and/or platelet at baseline, Time to deterioration in physical functioning, as measured by the physical functioning domain of EORTC QLQ-C30, Change from baseline in fatigue, as measured by the Patient-Reported Outcomes Measurement Information System (PROMIS)-Fatigue SF 7a, Overall response (OR) defined as CR + PR

Source: https://euclinicaltrials.eu/ctis-public/view/2023-507153-16-00